EU clinical trial 2023-504594-20-00: ANRS0407s -LKV.Cov40. A phase 1/2 multicenter, randomized study of the safety and immunogenicity of a sub-unit protein CD40.RBDv bivalent COVID-19 vaccine, adjuvanted or not, as a booster in volunteers
Sponsor: Inserm (Laboratory/Research/Testing facility). Phase: Human Pharmacology (Phase I)- First administration to humans. Countries: France (ongoing, recruitment ended).
Therapeutic area(s): Diseases [C] - Virus Diseases [C02]
Gender: Female, Male. Age: 18-64 years, 65+ years. Enrolment: 215.
Status: Ongoing, recruitment ended. Start date (EU): 2025-01-06. Decision date: 2023-10-12. Results received: No. Last updated: 2026-06-25.

Condition(s): Healthy volunteers

Source: https://euclinicaltrials.eu/ctis-public/view/2023-504594-20-00